EU clinical trial 2024-513882-38-00: TACE-3: A two-arm multi-stage (TAMS) seamless phase II/III randomised trial of nivolumab in combination with TACE/TAE for patients with intermediate stage HCC
Protocol code: ISRCTN12053408
Sponsor: The Clatterbridge Cancer Centre NHS Foundation Trust (Hospital/Clinic/Other health care facility). Phase: Phase II and Phase III (Integrated). Countries: France (ongoing, recruitment ended).
Therapeutic area(s): Diseases [C] - Neoplasms [C04]
Gender: Female, Male. Age: 18-64 years, 65+ years. Enrolment: 11.
Status: Ongoing, recruitment ended. Start date (EU): 2022-10-12. Decision date: 2024-11-08. Results received: No. Last updated: 2025-09-24.

Condition(s): Intermediate stage Hepatocellular carcinoma
Product: DOXORUBICIN, EPIRUBICIN, CISPLATIN, OPDIVO 10 mg/mL concentrate for solution for infusion., MITOMYCIN, LIPIODOL ULTRA FLUIDE 480 mg/ml, solution injectable, IDARUBICIN

Primary endpoint: Phase II component : Time to TACE/TAE Progression (TTTP), Phase III component : Overall Survival
Endpoint(s): Phase II component : Number of Grade 3+ AEs and SAEs, Phase II component : Progression Free Survival (PFS), Phase II component : Time to progression (TTP), Phase II component : Response rate by RECIST 1.1, Phase III component : Time to TACE/TAE Progression (TTTP), Phase III component : Number of Grade 3+ AEs and SAEs, Phase III component : Progression Free Survival (PFS), Phase III component : Time to progression (TTP), Phase III component : Objective response rate (ORR) by RECIST 1.1, Phase III component : EORTC QLQ_C30 EORTC QLQ-HCC18 EQ5D

Source: https://euclinicaltrials.eu/ctis-public/view/2024-513882-38-00